EU clinical trial 2025-525106-37-00: Comparative study of two vaccination schedules for the subunit Herpes Zoster vaccine in Multiple Sclerosis and Neuromyelitis optica spectrum disease patients treated with anti-CD20 therapy: an open-label randomised controlled trial.
Protocol code: RC31/25/0535
Sponsor: Centre Hospitalier Universitaire De Toulouse (Hospital/Clinic/Other health care facility). Phase: Therapeutic use (Phase IV). Countries: France (authorised, recruitment pending).
Therapeutic area(s): Diseases [C] - Nervous System Diseases [C10]
Gender: Female, Male. Age: 18-64 years. Enrolment: 160.
Status: Authorised, recruitment pending. Decision date: 2026-07-28. Results received: No. Last updated: 2026-07-28.

Condition(s): Multiple Sclerosis and Neuromyelitis optica spectrum
Product: OCRELIZUMAB, RITUXIMAB, Shingrix suspension for injection in pre-filled syringe Herpes zoster vaccine (recombinant, adjuvanted)

Primary endpoint: Humoral Vaccine Response Rate (VRR) measured 1 month after the 2nd vaccine dose (M3 for the “2 months” group and M7 for the “6 months” group), defined as the proportion of patients with at least a 4-fold increase in anti-VZV gE antibody titers (measured by ELISA) compared to baseline (M0), or seroconversion for those who were seronegative at M0.
Endpoint(s): Ratio (M0-M6 versus M0-M2 groups) of the adjusted Geometric Mean Titer (GMT) of anti-VZV gE IgG at 1 month after the 2nd vaccine dose., 2. Geometric Mean Titer (GMT) of anti-VZV gE IgG measured at baseline (M0) and up to M13: before the 2nd vaccine dose, 1 month after the 2nd vaccine dose, and prior to the next anti CD20 infusions: M7 and M13., 3. Humoral VRR at M13, 4. Cellular VRR for gE-specific CD4[AIM+] T response measured 1 month after the 2nd vaccine dose., Proportion of gE-specific CD4[AIM+] T cells among CD4 T cells measured at baseline (M0) and up to M13: before the 2nd vaccine dose, 1 month after the 2nd vaccine dose, and prior to the next anti-CD20 infusions: M7 and M13., Cellular VRR measured at M13., Adverse Events

Source: https://euclinicaltrials.eu/ctis-public/view/2025-525106-37-00